EU clinical trial 2025-521267-13-01: An open-label, randomized clinical trial comparing Etacizin versus Propafenone in Atrial Fibrillation
Protocol code: OF_ETA_CT1
Sponsor: Olpha AS (Pharmaceutical company). Phase: Therapeutic use (Phase IV). Countries: Latvia (authorised, recruitment pending).
Therapeutic area(s): Diseases [C] - Cardiovascular Diseases [C14]
Gender: Female, Male. Age: 18-64 years, 65+ years. Enrolment: 30.
Status: Authorised, recruitment pending. Decision date: 2025-09-11. Results received: No. Last updated: 2025-09-11.

Condition(s): Atrial fibrillation
Product: Etacizīns 50 mg apvalkotās tabletes, PROPAFENONE

Primary endpoint: Recurrence of atrial fibrillation over 6 months of the treatment after restored sinus rhythm
Endpoint(s): Proportion of participants with pharmacological cardioversion during Phase I, The proportion of participants who meet clinical criteria for electrical cardioversion during Phase II, Time of recurrence of atrial fibrillation during Phase II, Change in Atrial fibrillation effect on quality of life from baseline to study end, Rate of hospitalizations related to atrial fibrillation during Phase II, A composite of cardiovascular death, myocardial infarction, acute coronary revascularization, and stroke (MACE), The heart rate variabilty in treatment groups

Source: https://euclinicaltrials.eu/ctis-public/view/2025-521267-13-01